EU clinical trial 2024-515346-17-00: Treatment effects of Bisoprolol and Verapamil in symptomatic patients with non-obstructive hypertrophic cardiomyopathy
Sponsor: Region Midtjylland (Hospital/Clinic/Other health care facility). Phase: Therapeutic use (Phase IV). Countries: Denmark (ongoing, recruiting).
Therapeutic area(s): Diseases [C] - Cardiovascular Diseases [C14]
Gender: Female, Male. Age: 18-64 years, 65+ years. Enrolment: 140.
Status: Ongoing, recruiting. Start date (EU): 2022-08-01. Decision date: 2024-07-04. Results received: No. Last updated: 2025-02-14.

Condition(s): Non-obstructive hypertrophic cardiomyopathy
Product: BISOPROLOL, Placebotablet 8 mm, VERAPAMIL

Primary endpoint: Phase 1: The maximal oxygen consumption (VO2 max) is different (ΔVO2 max ≥1 ml/kg/min) between treatments in non-obstructive HCM patients, Phase 2: The left ventricular enddiastolic volume (LVvol) is different (ΔLVvol ≥3 ml) between treatments in non-obstructive HCM patients., Phase 3: The incidence of non-sustained ventricular tachycardia (NSVT) is different (Hazard ratio ≥ 0.5) between treatments in non-obstructive HCM patients.
Endpoint(s): Sex specific analyses of effect parameters, Kansas City Cardiomyopathy Questionnaire (KCCQ) score, New York Heart Association (NYHA) functional classification, Canadian Cardiovascular Society (CCS), Tolerable dose, Pro-BNP/BNP, High sensitive Troponin I/Troponin T, Recovery time during CPET, VO2 max at anaerobic threshold during CPET, Percent predicted VO2 max during CPET, Ventilatory equivalent for carbon dioxide VE/VCO2 during CPET, Metabolic equivalent of task (METs) during CPET, Left ventricular end-diastolic dimension during echocardiography, Myocardial deformation imaging (Strain) during echocardiography, Left ventricular outflow tract time velocity intergral (VTI) during echocardiography, Left atrial dimension during echocardiography, Left ventricular systolic function during CMRI, Right ventricular dimensions during CMRI, Right ventricular systolic function during CMRI, Stroke volume (Aortic flow) during CMRI, Coronary sinus flow during CMRI, Dimension of inferior and superior caval vein during CMRI, Left atrial dimension during CMRI, Atrial fibrillation (Ambulatory ECG monitoring), Estimation of ventricular ectopic beats (Ambulatory ECG monitoring)

Source: https://euclinicaltrials.eu/ctis-public/view/2024-515346-17-00